EU clinical trial 2024-515781-13-00: Benefit of positons emission tomography / 68Gallium citrate tomodensitometry for artificial hip and knee chronic infection diagnosis
Protocol code: CHUBX 2019/24
Sponsor: Centre Hospitalier Universitaire De Bordeaux (Hospital/Clinic/Other health care facility). Phase: Therapeutic exploratory (Phase II). Countries: France (ongoing, recruiting).
Therapeutic area(s): Analytical, Diagnostic and Therapeutic Techniques and Equipment [E] - Investigative Techniques [E05]
Gender: Female, Male. Age: 18-64 years, 65+ years. Enrolment: 35.
Status: Ongoing, recruiting. Start date (EU): 2022-02-02. Decision date: 2024-08-12. Results received: No. Last updated: 2025-08-25.

Condition(s): Prosthetic joint infection
Product: 68 Gallium citrate

Primary endpoint: Diagnostic accuracy setting's assessment of the 68Ga citrate PET/TDM for chronic infection diagnosis of artificial hip or knee (sensibility, specificity, predictive positive and negative value).
Endpoint(s): Reproducibility inter- observers of 68Ga citrate PET/TDM interpretation, Diagnostic accuracy setting's assessment of marked polynuclear scintigraphy, Diagnosis accuracy's assessment of 68Ga citrate PET/TDM and marked polynuclear scintigraphy for both under-populations: artificial knee or hip infection, Comparison of diagnostic accuracy setting of 68Ga citrate PET/TDM and marked polynuclear scintigraphy., Kind of discrepancy between the two exams

Source: https://euclinicaltrials.eu/ctis-public/view/2024-515781-13-00